EU clinical trial 2024-518501-17-00: A multicenter double-blind, randomized, placebo-controlled phase I/II study to determine the safety, tolerability, potential efficacy and dose finding of INP20, an oral formulation for treatment of immunotherapy in peanut-allergic patients.
Protocol code: INP20-01
Sponsor: Innoup Farma S.L. (Pharmaceutical company). Phase: Phase I and Phase II (Integrated)- First administration to humans. Countries: Spain (authorised, recruitment pending).
Therapeutic area(s): Diseases [C] - Immune System Diseases [C20]
Gender: Female, Male. Age: 0-17 years, 18-64 years, 65+ years. Enrolment: 84.
Status: Authorised, recruitment pending. Decision date: 2024-10-31. Results received: No. Last updated: 2024-10-31.

Condition(s): Peanut allergy
Product: Placebo product for INP20

Primary endpoint: Part A: Dose-ranging study (dose escalation): Incidence of adverse events (AEs), serious adverse events (SAEs), treatment-related AEs/SAEs, and AEs/SAEs leading to discontinuation will be calculated and classified by body system and preferred term using MedDRA dictionary and EAACI guidelines criteria., Part A: Dose-ranging study (dose escalation): Systemic allergic symptoms and relatedness to treatment., Part A: Dose-ranging study (dose escalation): Physical examination and vital signs., Part A: Dose-ranging study (dose escalation): Peak flow., Part A: Dose-ranging study (dose escalation): Biological safety (laboratory): hematology, coagulation, biochemistry, urinalysis, and immunologic tests., Part A: Dose-ranging study (dose escalation): Number of participants with Dose-limiting toxicities (DLT)., Part B: Parallel Group Extension study: Incidence of adverse events (AEs), serious adverse events (SAEs), treatment-related AEs/SAEs, and AEs/SAEs leading to discontinuation will be calculated and classified by body system and preferred term using MedDRA dictionary and EAACI guidelines criteria., Part B: Parallel Group Extension study: Systemic allergic symptoms and relatedness to treatment., Part B: Parallel Group Extension study: Physical examination and vital signs., Part B: Parallel Group Extension study: Peak flow., Part B: Parallel Group Extension study: Biological safety (laboratory): hematology, coagulation, biochemistry, urinalysis, and immunologic tests.
Endpoint(s): Part A: Dose-ranging study (dose escalation): The change in Immunoglobulin G subtype (IgG4) (as biomarkers of immunogenicity of allergen-specific immunotherapy) at the end of treatment and at month 1, month 2 and month 3., Part B: Parallel Group Extension study: To detect differences in increases in reaction thresholds (challenge scores) to peanut of treatment groups versus the placebo after 6 months of INP20 treatment. Challenges scores will be measured by the amount of cumulative peanut protein participants are able to ingest successfully without symptoms of an allergic reaction., Part B: Parallel Group Extension study: Outcome variables of interest will include peanut specific IgE, IgG, and IgG4 response against complete extract and some allergenic components of peanut; specific basophil activation against NP, NP-peanut and peanut raw extract; mast cell responses through skin prick testing and endpoint titration; and specific T-cell cytokine responses (IL10, TGF-beta, IL4, IL5 and IL13) and T regulatory cell (Treg) activation (subpopulation Treg1 CD4+ CD25+).

Source: https://euclinicaltrials.eu/ctis-public/view/2024-518501-17-00